EU clinical trial 2026-526411-11-00: A Safety Study to Test a New Medicine (ANT3310) Alone and When Taken with an Antibiotic (Meropenem) in Healthy Adult Participants.
Protocol code: ANT3310-1006
Sponsor: Antabio (Pharmaceutical company). Phase: Human Pharmacology (Phase I)- Other. Countries: France (ongoing, recruiting).
Therapeutic area(s): Not possible to specify
Gender: Female, Male. Age: 18-64 years. Enrolment: 40.
Status: Ongoing, recruiting. Start date (EU): 2026-06-15. Decision date: 2026-06-12. Results received: No. Last updated: 2026-06-12.

Condition(s): Not applicable for phase I study

Source: https://euclinicaltrials.eu/ctis-public/view/2026-526411-11-00